EU clinical trial 2024-516416-22-00: MIBI-THYR : Value of the combination ultrasonography with Ti-RADS score / dual tracer scintigraphy MIBI-Tc99m/Iodine-123 in the detection of malignancy of thyroid nodules (≥15 mm) classified Bethesda III or IV on cytology
Protocol code: RC18_0052
Sponsor: Centre Hospitalier Universitaire De Nantes (Hospital/Clinic/Other health care facility). Phase: Phase II and Phase III (Integrated). Countries: France (ended).
Therapeutic area(s): Diseases [C] - Hormonal diseases [C19]
Gender: Female, Male. Age: 18-64 years, 65+ years. Enrolment: 375.
Status: Ended. Start date (EU): 2019-01-17. End date (EU): 2025-05-07. Decision date: 2024-10-07. Results received: No. Last updated: 2024-10-07.

Condition(s): malignancy of thyroid nodules

Source: https://euclinicaltrials.eu/ctis-public/view/2024-516416-22-00